EU clinical trial 2024-511426-31-00: A prospective, single-centre, randomised, double-blind, placebo-controlled, phase I, First-In-Human (FIH) trial evaluating the safety and tolerability of single and multiple ascending oral doses of IRL757 in healthy volunteers.
Protocol code: IRL757C001
Sponsor: Integrative Research Laboratories Sweden AB (Pharmaceutical company). Phase: Human Pharmacology (Phase I)- First administration to humans. Countries: Sweden (ended).
Therapeutic area(s): Diseases [C] - Nervous System Diseases [C10]
Gender: Female, Male. Age: 18-64 years. Enrolment: 82.
Status: Ended. Start date (EU): 2024-05-16. End date (EU): 2025-02-07. Decision date: 2024-05-03. Results received: No. Last updated: 2024-12-11.

Condition(s): Apathy in neurodegenerative disorders

Source: https://euclinicaltrials.eu/ctis-public/view/2024-511426-31-00